EU clinical trial 2024-518312-40-00: KF2022#1 trial: The effect of fecal microbiota transplantation on CYP enzyme activities
Sponsor: HUS-Yhtymae (Hospital/Clinic/Other health care facility). Phase: Human Pharmacology (Phase I)- Other. Countries: Finland (ongoing, recruiting).
Therapeutic area(s): Phenomena and Processes [G] - Metabolism [G03]
Gender: Female, Male. Age: 18-64 years, 65+ years. Enrolment: 25.
Status: Ongoing, recruiting. Start date (EU): 2023-01-05. Decision date: 2024-10-21. Results received: No. Last updated: 2024-10-21.

Condition(s): Irritable bowel syndrome, Clostridioides difficile

Source: https://euclinicaltrials.eu/ctis-public/view/2024-518312-40-00